EU clinical trial 2024-513327-16-00: ASPIC - Antimicrobial Stewardship for Ventilator Associated Pneumonia in Intensive Care
Protocol code: APHP200011
Sponsor: Assistance Publique Hopitaux De Paris (Hospital/Clinic/Other health care facility). Phase: Therapeutic confirmatory (Phase III). Countries: France (ongoing, recruiting).
Therapeutic area(s): Diseases [C] - Respiratory Tract Diseases [C08]; Diseases [C] - Bacterial Infections and Mycoses [C01]
Gender: Female, Male. Age: 18-64 years, 65+ years. Enrolment: 590.
Status: Ongoing, recruiting. Start date (EU): 2022-09-20. Decision date: 2024-09-09. Results received: No. Last updated: 2026-07-23.

Condition(s): Intensive care, Ventilator Associated Pneumonia
Product: AMOXICILLINE/ACIDE CLAVULANIQUE PANPHARMA 2 g/200 mg ADULTES, poudre pour solution injectable

Primary endpoint: The primary endpoint is a composite endpoint with non-inferiority criteria including: 1. all-cause mortality (ACM) measured at day 28 after initiation of antibiotic therapy OR 2. Treatment failure defined by signs of pneumonia within 72 hours after the end antibiotic therapy at the test of cure visit OR 3. New episode of microbiologically confirmed VAP from 72 hours after the end antibiotic treatment to day 28 after initiation of VAP antibiotic treatment
Endpoint(s): 1) Rate of all-cause mortality, 2) Rate of treatment failure, 3) Rate of new episode of VAP, 4) Number of antibiotic free alive-days from initiation of VAP antibiotic therapy to day 28, 5) Global score constructed with the DOOR and RADAR. Overall clinical outcome at day 28, from most to least desirable are: 1. Survival, clinical cure 2. Survival, new pulmonary infection 3. Death, 6) Duration of invasive MV, at day 28 after inclusion, defined as total of days under MV, 7) Length of ICU stay at day 28 after inclusion, defined by the number of days between inclusion and ICU discharge or in-ICU death., 8) Rate of VAP recurrence by the intensivist at day 28, 9) Rate of antibiotic related side effects, 10) Rate of acquisition of MDR bacteria at day 28 defined as the identification of a MDR bacteria carriage not present at admission, 11) Rate of death at days 28 and 90 at day 28, 12) Rate of non-interruption of antibiotic therapy despite a positive clinical cure in the intervention group only at day 28 after inclusion., 13) Total cumulative costs of antibiotics at day 28 and incremental cost effectiveness ratio

Source: https://euclinicaltrials.eu/ctis-public/view/2024-513327-16-00